EU clinical trial 2025-522853-21-01: An open label, phase I/II study investigating the safety and efficacy of a CD3/CD20 bispecific T-cell engager therapy in patients with active, treatment refractory, ANCA-IgG-positive associated vasculitis. The RENEWAL study
Protocol code: TMP-05062025-1
Sponsor: Fraunhofer Institute For Translational Medicine And Pharmacology ITMP (Laboratory/Research/Testing facility). Phase: Phase I and Phase II (Integrated)- Other. Countries: Germany (ongoing, recruiting).
Therapeutic area(s): Diseases [C] - Immune System Diseases [C20]
Gender: Female, Male. Age: 18-64 years, 65+ years. Enrolment: 8.
Status: Ongoing, recruiting. Start date (EU): 2026-02-27. Decision date: 2026-01-30. Results received: No. Last updated: 2026-01-30.

Condition(s): Active, treatment refractory, ANCA-IgG-positive associated vasculitis
Product: CND261

Primary endpoint: Phase I: Incidence and grading of severity of Cytokine Release Syndrome (CRS), Immune Cell Associated Neurotoxicity Syndrome (ICANS) and treatment-related adverse events (AE) and serious adverse events (SAE) due to IMP until 28 days after the last administration of CD3/CD20 TCE therapy (CND261)., Phase II: Safety and ANCA seroconversion rate of CD3/CD20 TCE therapy (CND261) in participants with active, treatment refractory, ANCA-IgG-positive AAV, Incidence and grading of severity of Cytokine Release Syndrome (CRS), Immune Cell Associated Neurotoxicity Syndrome (ICANS) and treatment-related adverse events (AE) and serious adverse events (SAE) due to IMP until 28 days after the last administration of CD3/CD20 TCE therapy (CND261)., Percentage of patients with ANCA seroconversion after CD3/CD20 TCE (CND261) therapy (normal anti-PR3 antibodies for GPA patients and normal anti-MPO antibodies for MPA patients) at week 24
Endpoint(s): Clinical response: Duration without DMARD therapy from week 5 to week 52, Clinical response: Percentage of patients who reach EULAR sustained remission criteria (absence of typical signs, symptoms, or other features of active AAV) through week 52, Clinical response: Time until clinical relapse or flare observed between week 5 and week 52, Clinical response: Number of flares from week 5 through weeks, Clinical response: Cumulative steroid dosage from week 5 to week 52, Clinical response: Percentage of patients who reach EULAR response criteria (≥ 50% reduction of Birmingham Vasculitis Activity Score (BVAS) at week 8, 12, 24 and 52) compared to baseline, Clinical response: Change of Vasculitis Damage Index (VDI) at week 8, 12, 24 and 52 compared to baseline, Clinical response: Change in Birmingham Vasculitis Activity Score (BVAS) at week 8, 12, 24 and 52 compared to baseline, Clinical response: Change in patient’s Global Assessment (PtGA) of disease activity (VAS 0-100mm) over time, Change in physician’s Global Assessment (PhGA) of disease activity (VAS 0-100mm) over time, Clinical response: Change in Short Form 36 (SF-36, quality of life questionnaire) over time, Clinical response: Change in Health Assessment Questionnaire Disability Index (HAQ-DI) over time, Cellular and humoral response: Percentage of patients with ANCA seroconversion after CD3/CD20 TCE (CND261) therapy (normal anti-PR3 antibodies for GPA patients and normal anti-MPO antibodies for MPA patients) at week 8, 24 (Phase I), 12, and 52, Cellular and humoral response: Change in levels of anti-PR3 antibodies (GPA) and anti-MPO antibodies (MPA) over time, Cellular and humoral response: Change in the number of CD20+ B cell numbers over time, Cellular and humoral response: Change in levels of total IgG, IgA, IgM immunoglobulins over time, Cellular and humoral response: Change in eGFR and levels of CRP over time, Safety: Any AE and SAE until end of study, Safety: Type and severity, seriousness and relatedness of AEs

Source: https://euclinicaltrials.eu/ctis-public/view/2025-522853-21-01